EU clinical trial 2023-506452-25-00: Comparison of ustekinumab, infliximab and COMBinatiOn therapy in moderately-to-severely active Ulcerative Colitis – the head-to-head COMBO-UC trial.
Protocol code: COMBO/2022/3
Sponsor: Medical University Of Lodz (Educational Institution). Phase: Therapeutic exploratory (Phase II). Countries: Poland (ongoing, recruiting).
Therapeutic area(s): Diseases [C] - Digestive System Diseases [C06]
Gender: Female, Male. Age: 18-64 years. Enrolment: 172.
Status: Ongoing, recruiting. Start date (EU): 2025-03-27. Decision date: 2024-04-12. Results received: No. Last updated: 2026-02-03.

Condition(s): Ulcerative colitis
Product: USTEKINUMAB, INFLIXIMAB, USTEKINUMAB

Primary endpoint: Percentage of clinical and endoscopic remission after remission induction phase.
Endpoint(s): Percentage of clinical response after remission induction phase., Percentage of clinical response at 52 wks., Percentage of clinical remission at 52 wks., Percentage of endoscopic remission or endoscopic improvement after the remission induction phase and at 52 wks., Percentage of laboratory remissions after the remission induction phase and at 52 weeks., Percentage of deep remissions after the remission induction phase and at 52 wks., Comparison of patients' quality of life after the remission induction phase and at 52 wks., Comparison of the number and type of adverse events and serious adverse events after the remission induction phase and at 52 wks.

Source: https://euclinicaltrials.eu/ctis-public/view/2023-506452-25-00